EU clinical trial 2024-510628-38-00: A study in healthy men to test whether zongertinib influences the amount of 4 other medicines (dabigatran, rosuvastatin, metformin, and furosemide) in the blood
Protocol code: 1479-0015
Sponsor: Boehringer Ingelheim International GmbH (Pharmaceutical company). Phase: Human Pharmacology (Phase I)- Other. Countries: Germany (ended).
Therapeutic area(s): Not possible to specify
Gender: Male. Age: 18-64 years. Enrolment: 32.
Status: Ended. Start date (EU): 2024-08-19. End date (EU): 2024-12-12. Decision date: 2024-07-08. Results received: No. Last updated: 2024-07-08.

Condition(s): Pharmacokinetic trial

Source: https://euclinicaltrials.eu/ctis-public/view/2024-510628-38-00